EU clinical trial 2024-517312-30-00: Effect of recombinant FSH dosing following corifollitropin alfa in patients undergoing IVF/ICSI in a GnRH antagonist protocol: a randomized controlled dose-finding study.
Sponsor: UZ Brussel (Hospital/Clinic/Other health care facility). Phase: Therapeutic use (Phase IV). Countries: Belgium (ongoing, recruitment ended).
Therapeutic area(s): Diseases [C] - Female Urogenital Diseases and Pregnancy Complications [C13]
Gender: Female. Age: 18-64 years. Enrolment: 261.
Status: Ongoing, recruitment ended. Start date (EU): 2019-06-19. Decision date: 2024-10-04. Results received: No. Last updated: 2024-10-04.

Condition(s): Subfertility in need of ICSI treatment
Product: Puregon 900 IU/1.08 mL solution for injection, Puregon 300 IU/0.36 mL solution for injection, Puregon 600 IU/0.72 mL solution for injection, Elonva 150 micrograms solution for injection

Primary endpoint: Mean serum P level on trigger day
Endpoint(s): Number of COCs retrieved, Number of patients who underwent FA, Clinical pregnancy rate, Ongoing pregnancy rate, Miscarriage rate, Live birth rate

Source: https://euclinicaltrials.eu/ctis-public/view/2024-517312-30-00